EU clinical trial 2025-523717-29-00: Efficacy and safety of NNC0487-0111 compared to placebo on morbidity and mortality in people with heart failure with preserved or mildly reduced ejection fraction and obesity (HF-POLARIS).
Protocol code: NN9490-8266
Sponsor: Novo Nordisk A/S (Pharmaceutical company). Phase: Therapeutic confirmatory (Phase III). Countries: Denmark (ongoing, recruiting), Greece (ongoing, recruiting), Bulgaria (ongoing, recruiting), Italy (ongoing, recruiting), Netherlands (ongoing, recruiting), Spain (ongoing, recruiting), Poland (ongoing, recruiting), Czechia (ongoing, recruiting), Germany (ongoing, recruiting), France (ongoing, recruiting).
Therapeutic area(s): Diseases [C] - Cardiovascular Diseases [C14]
Gender: Female, Male. Age: 18-64 years, 65+ years. Enrolment: 1992.
Status: Ongoing, recruiting. Start date (EU): 2026-04-28. Decision date: 2026-04-17. Results received: No. Last updated: 2026-08-03.
Decision dates by country: BG: 2026-05-04, DK: 2026-04-27, GR: 2026-04-17, IT: 2026-04-30, DE: 2026-04-20, PL: 2026-04-28, CZ: 2026-04-17, FR: 2026-04-17, NL: 2026-04-23, ES: 2026-04-27

Condition(s): HFpEF or HFmrEF and obesity
Product: NNC0487-0111 B 10142, NNC0487-0111 B 10144, NNC0487-0111 B 10146, NNC0487-0111 B 10141, Placebo (NNC0487-0111), NNC0487-0111 B 10143, NNC0487-0111 B 10145

Primary endpoint: Time to first occurrence of a composite HF endpoint consisting of: CV death, HF hospitalisation or urgent HF visit
Endpoint(s): Time to first occurrence of a composite HF and MACE endpoint consisting of: CV death, HF hospitalisation or urgent HF visit, Nonfatal MI, Nonfatal stroke, Change in KCCQ-CSS for participants with baseline KCCQ‑CSS score <80 points, Change in eGFR (creatinine and cystatin C‑based CKD‑EPI 2021) for participants with baseline eGFR<60 mL/min/1.73 m2, Time to all-cause death, CCI, CCI, CCI, CCI, CCI, CCI, CCI, CCI, CCI, CCI, CCI, CCI, CCI, CCI, CCI, CCI, CCI, CCI, CCI, CCI, CCI, CCI, CCI, CCI, CCI, CCI, CCI, CCI, CCI

Source: https://euclinicaltrials.eu/ctis-public/view/2025-523717-29-00